EU clinical trial 2022-502950-14-00: A 24-Month, Multi-Centre, Open Label Phase IV Post Authorisation Efficacy Study to Evaluate the Efficacy, Safety and Immunogenicity of Daily Subcutaneous Metreleptin Treatment in Patients with Partial Lipodystrophy
Protocol code: APL-22
Sponsor: Chiesi Farmaceutici S.p.A. (Pharmaceutical company). Phase: Therapeutic use (Phase IV). Countries: Italy (ongoing, recruiting), Germany (authorised, recruiting), France (ongoing, recruiting).
Therapeutic area(s): Phenomena and Processes [G] - Metabolism [G03]
Gender: Female, Male. Age: 0-17 years, 18-64 years, 65+ years. Enrolment: 9.
Start date (EU): 2023-12-08. Decision date: 2023-10-10. Results received: No. Last updated: 2026-04-13.
Decision dates by country: IT: 2023-10-10, DE: 2023-10-11, FR: 2023-10-10

Condition(s): Partial Lipodystrophy
Product: Myalepta 3 mg powder for solution for injection, Myalepta 5.8 mg powder for solution for injection, Myalepta 3 mg powder for solution for injection, Myalepta 11.3 mg powder for solution for injection, Myalepta 11.3 mg powder for solution for injection, Myalepta 5.8 mg powder for solution for injection

Primary endpoint: Number of patients with decrease of at least 0.5% in glycated haemoglobin (HbA1c) at Month 12 compared to Baseline or HbA1c <6.5 % at Month 12, in patients with baseline HbA1c ≥6.5%., Number of patients with decrease of at least 30% in triglycerides (TG) at Month 12 compared to Baseline, in patients with baseline TG levels ≥500 mg/dL (5.65 mmol/L).
Endpoint(s): Number of patients with decrease of at least 0.5% in HbA1c at Month 24 compared to Baseline or HbA1c <6.5 % at Month 24, in patients with baseline HbA1c ≥6.5%., Number of patients with decrease of at least 30% in TG levels at Month 24 compared to Baseline, in patients with baseline TG levels ≥500 mg/dL (5.65 mmol/L)., Change from baseline in HbA1c at Month 12 and Month 24 in patients with baseline HbA1c ≥6.5% (Subgroup analysis for patients with HbA1c ≥8% will be conducted), Percent change from baseline in TG levels at Month 12 and Month 24 in patients with baseline TG ≥500 mg/dL (5.65 mmol/L)., Number of patients achieving at least 1 of the below criteria: o 0.5% decrease in HbA1c at Month 12 compared to Baseline or HbA1c <6.5 % at Month 12 o 30% decrease in fasting serum TG at Month 12, Change from baseline in liver volume at Month 12 and Month 24., Change from baseline in Homeostatic Model Assessment of Insulin Resistance (HOMAIR) (fasting glucose and insulin) in noninsulin treated patients at Month 12 and Month 24., Number of patients who maintained, decreased, or increased dose and/or dosing frequency of anti-diabetic medications., Number of patients who maintained, decreased, or increased dose and/or dosing frequency of lipid-lowering medications., Number of patients with ≥25% reduction in insulin requirements at Month 12 and Month 24.

Source: https://euclinicaltrials.eu/ctis-public/view/2022-502950-14-00